EU clinical trial 2025-521908-22-00: IZABRIGHT-Lung01: A Randomized, Open-label, Phase 2/3 Study of Izalontamab Brengitecan (BMS-986507) versus Platinum-based Chemotherapy in Patients with EGFR-mutated Non-small Cell Lung Cancer and Disease Progression on EGFR Tyrosine Kinase Inhibitor Therapy
Protocol code: CA244-0010
Sponsor: Bristol-Myers Squibb Services Unlimited Company (Pharmaceutical company). Phase: Phase II and Phase III (Integrated). Countries: Poland (authorised, recruitment pending), Germany (authorised, recruitment pending), Italy (authorised, recruitment pending), Norway (authorised, recruitment pending), Netherlands (authorised, recruitment pending), Belgium (authorised, recruitment pending), Romania (authorised, recruitment pending), France (authorised, recruitment pending), Greece (authorised, recruitment pending), Spain (authorised, recruitment pending).
Therapeutic area(s): Diseases [C] - Neoplasms [C04]
Gender: Female, Male. Age: 18-64 years, 65+ years. Enrolment: 193.
Status: Authorised, recruitment pending. Decision date: 2026-01-19. Results received: No. Last updated: 2026-01-28.
Decision dates by country: BE: 2026-01-21, FR: 2026-01-26, DE: 2026-01-21, GR: 2026-01-19, IT: 2026-01-21, RO: 2026-01-26, ES: 2026-01-21, NO: 2026-01-22, PL: 2026-01-26, NL: 2026-01-28

Condition(s): EGFR-mutated Non-small Cell Lung Cancer
Product: CARBOPLATIN, CISPLATIN, PEGFILGRASTIM, PEMETREXED, BL-B01D1

Primary endpoint: Phase 2: RP3D determined based on the totality of safety, tolerability, efficacy, and PK/pharmacodynamic data, Phase 3: progression-free survival by RECIST v1.1 per Blinded Independent Central Review.
Endpoint(s): Phase 2: Overall Survival by RECIST v1.1 per Blinded Independent Central Review, Phase 2: Progression-Free Survival rates by RECIST v1.1 per Blinded Independent Central Review, Phase 3: overall survival (OS).

Source: https://euclinicaltrials.eu/ctis-public/view/2025-521908-22-00